EU clinical trial 2025-523426-40-00: Allergen extract of Lepidoglyphus destructor. Study of the sensitivity and specificity of the diagnostic preparation in prick tests
Protocol code: M603-SSP-081
Sponsor: Inmunotek S.L. (Pharmaceutical company). Phase: Therapeutic confirmatory (Phase III). Countries: Spain (authorised, recruitment pending).
Therapeutic area(s): Diseases [C] - Immune System Diseases [C20]
Gender: Female, Male. Age: 0-17 years, 18-64 years, 65+ years. Enrolment: 70.
Status: Authorised, recruitment pending. Decision date: 2026-06-01. Results received: No. Last updated: 2026-06-01.

Condition(s): Allergy to Lepidoglyphus destructor
Product: Skin Prick Test Negative control, Lepidoglyphus destructor extract 450 µg/mL solution for skin-prick test, Skin Prick Test Positive control

Primary endpoint: Area (mm²) of wheals induced by different concentrations of the L. destructor allergen extract, as well as the areas of wheals induced by the positive control and negative control, using the prick test
Endpoint(s): Safety parameters: • Overall rate, seriousness, and ratio of any adverse event (AE) by administration and by subject • Assessment of administration site reactions, systemic reactions and any medication administered for the treatment of adverse reaction (AR), Allergen profiling (ALEX technique)

Source: https://euclinicaltrials.eu/ctis-public/view/2025-523426-40-00